EU clinical trial 2024-513991-16-00: A Phase 2, Randomized, Placebo-Controlled Trial to Assess the Efficacy and Safety of Mosliciguat in Participants with Pulmonary Hypertension Associated with Interstitial Lung Disease
Protocol code: RVT-2301-201
Sponsor: Pulmovant Inc. (Pharmaceutical company). Phase: Therapeutic exploratory (Phase II). Countries: Netherlands (ongoing, recruitment ended), Italy (ongoing, recruitment ended), Belgium (ongoing, recruitment ended), France (ongoing, recruitment ended), Germany (ongoing, recruitment ended), Czechia (ongoing, recruitment ended), Poland (ongoing, recruitment ended), Latvia (ongoing, recruitment ended), Spain (ongoing, recruitment ended).
Therapeutic area(s): Diseases [C] - Cardiovascular Diseases [C14]
Gender: Female, Male. Age: 18-64 years, 65+ years. Enrolment: 96.
Status: Ongoing, recruitment ended. Start date (EU): 2025-01-17. Decision date: 2024-12-11. Results received: No. Last updated: 2026-03-03.
Decision dates by country: BE: 2024-12-20, CZ: 2024-12-18, FR: 2024-12-11, DE: 2024-12-20, IT: 2024-12-20, LV: 2024-12-18, ES: 2024-12-12, NL: 2024-12-14, PL: 2024-12-20

Condition(s): Pulmonary Hypertension Associated with Interstitial Lung Disease
Product: Colorless, clear, hard capsules for inhalation, MOSLICIGUAT, MOSLICIGUAT, MOSLICIGUAT

Primary endpoint: Percent change from baseline in PVR assessed at estimated peak exposure at Week 16 (%ΔPVR16) by right heart catheterization (RHC)
Endpoint(s): 1. Change in 6MWD from baseline measured at estimated peak exposure at Week 16 using the 6-Minute Walk Test (6MWT), 2. Change from baseline in NT-proBNP at Week 16

Source: https://euclinicaltrials.eu/ctis-public/view/2024-513991-16-00